EU clinical trial 2024-515743-27-00: An open-label trial of the long-term safety and tolerability of nintedanib per os, on top of standard of care, over at least 3 years, in children and adolescents with clinically significant fibrosing Interstitial Lung Disease (InPedILD®-ON)
Protocol code: 1199-0378
Sponsor: Boehringer Ingelheim International GmbH (Pharmaceutical company). Phase: Therapeutic confirmatory (Phase III). Countries: Belgium (ended), Portugal (ended), Italy (ended), Norway (ended), France (ended), Czechia (ended), Greece (ended), Poland (ended).
Therapeutic area(s): Diseases [C] - Respiratory Tract Diseases [C08]
Gender: Female, Male. Age: 0-17 years. Enrolment: 20.
Status: Ended. Start date (EU): 2022-04-04. End date (EU): 2025-08-01. Decision date: 2024-09-02. Results received: Yes. Last updated: 2025-10-27.
Decision dates by country: FR: 2024-09-24, BE: 2024-09-09, IT: 2024-09-09, CZ: 2024-09-05, PL: 2024-10-05, GR: 2024-11-13, NO: 2024-09-10, PT: 2024-09-02

Condition(s): Childhood Interstitial Lung Disease
Product: nintedanib, Nintedanib, nintedanib

Primary endpoint: The primary endpoint is the incidence of treatment emergent adverse events over the whole trial.

Source: https://euclinicaltrials.eu/ctis-public/view/2024-515743-27-00